EU clinical trial 2024-513915-28-00: A Phase 1b, Multicenter Study to Determine the Dose, Safety, Efficacy and Pharmacokinetics of TRK-950 when Used in Combinations with Selected Anti-Cancer Treatment Regimens in Patients with Selected Advanced Solid Tumors
Protocol code: 950P1V02
Sponsor: Toray Industries Inc. (Pharmaceutical company). Phase: Human Pharmacology (Phase I)- Other. Countries: France (ended).
Therapeutic area(s): Diseases [C] - Neoplasms [C04]
Gender: Female, Male. Age: 18-64 years, 65+ years. Enrolment: 32.
Status: Ended. Start date (EU): 2019-06-14. End date (EU): 2025-11-13. End date: 2026-07-16. Decision date: 2024-08-09. Results received: No. Last updated: 2025-02-07.

Condition(s): Bladder cancer, Cholangiocarcinoma, Colorectal Cancer, Epithelial Ovarian Cancer, Fallopian Tube Cancer, Gastric Cancer, Melanoma, Ovarian Cancer, Palpable Subcutaneous Malignant Lesions, Primary Peritoneal Cancer, Renal Cell Carcinoma, Solid Tumor

Source: https://euclinicaltrials.eu/ctis-public/view/2024-513915-28-00